EU clinical trial 2023-508117-16-00: Exploratory study to assess the pharmacokinetic interaction of doxepin with adrenaline after a concomitant co-administration using the Anapen® device and to compare the adrenaline comparative bioavailability with Anapen®500 commercial form in healthy normal weight male subjects
Protocol code: P23-01
Sponsor: Bioprojet Pharma (Pharmaceutical company). Phase: Human Pharmacology (Phase I)- Other. Countries: France (ended).
Therapeutic area(s): Diseases [C] - Cardiovascular Diseases [C14]
Gender: Male. Age: 18-64 years. Enrolment: 20.
Status: Ended. Start date (EU): 2024-05-03. End date (EU): 2024-09-04. Decision date: 2024-03-25. Results received: No. Last updated: 2024-03-25.

Condition(s): Anaphylaxis

Source: https://euclinicaltrials.eu/ctis-public/view/2023-508117-16-00